EU clinical trial 2023-507208-30-00: A Phase 2/3 Double-masked, Randomized, 2-stage, Multicenter Study of the Efficacy and Safety of OCS-01 Eye Drops in Subjects With Diabetic Macular Edema
Protocol code: DX219
Sponsor: Oculis Operations S.a.r.l. (Pharmaceutical company). Phase: Phase II and Phase III (Integrated). Countries: Spain (ended), Hungary (ended).
Therapeutic area(s): Phenomena and Processes [G] - Ocular Physiological Phenomena [G14]
Gender: Female, Male. Age: 18-64 years, 65+ years. Enrolment: 49.
Status: Ended. Start date (EU): 2022-09-20. End date (EU): 2024-07-29. Decision date: 2023-09-21. Results received: No. Last updated: 2024-04-12.
Decision dates by country: HU: 2023-09-21, ES: 2023-09-21

Condition(s): Diabetic Macular Edema (DME)
Product: Eye drops, suspension, ocular use

Primary endpoint: Stage 1: The primary efficacy endpoint for Stage 1 of this study is the mean change in Best Corrected Visual Acuity (BCVA) Early Treatment Diabetic Retinopathy Study (ETDRS) letters score at Visit 5 (Week 6) compared with baseline., Stage 2: The primary efficacy endpoint for Stage 2 in this study is the mean change in BCVA ETDRS letter score at Visit 12 (Week 52) compared with baseline.
Endpoint(s): Stage 1: The proportion of subjects with a 3 line or greater gain in BCVA assessedwith ETDRS scale at Visit 5 (Week 6) compared with baseline., Stage 1: • Area under the curve (AUC) of BCVA ETDRS letter changes across postbaseline visits up toWeek 6 and Week 12 compared with baseline., Stage 1: • Mean change in BCVA ETDRS letters score at Visit 7 (Week 12)compared with baseline and Visit 5 (Week 6)., Stage 1: • The proportion of subjects with a 3 line or greater gain in BCVA assessed with ETDRS scale at Visit 7 (Week 12) compared with baseline and Visit 5 (Week 6)., Stage 1: • Mean change in CST as measured by SD-OCT at Visit 5 (Week 6) and Visit 7 (Week 12) compared with baseline, and at Visit 7 (Week 12) compared with Visit 5 (Week 6)., Stage 1: • The proportion of subjects with a 1-line or greater and a 2-line or greater gain in BCVA assessed with the ETDRS scale at each postbaseline visit., Stage 1: • Mean change in CST as measured by SD--OCT compared with baseline at each postbaseline visit., Stage 2: The proportion of subjects with a 3-line or greater gain in BCVA assessed with the ETDRS scale at Visit 9 (Week 52) compared with baseline. Please refer to Clinical Study Protocol for Other Secondary Efficacy Endpoints (section 7.1.5) for both Stages., Other secondary efficacy endpoints: • AUC of BCVA ETDRS letter changes across postbaseline visits up to Visit 12 (Week 52). • Mean change in CST as measured by SD-OCT at Visit 12 (Week 52) compared with baseline. • Mean change in CST as measured by SD-OCT at each postbaseline visit compared with baseline., Other secondary efficacy endpoints: • Mean change in BCVA ETDRS letters score at each postbaseline visit compared with baseline. • The proportion of subjects with a 3 line or greater gain in BCVA assessed with ETDRS scale at each postbaseline visit.

Source: https://euclinicaltrials.eu/ctis-public/view/2023-507208-30-00